EU clinical trial 2024-514033-37-00: Treatment of refractory Crohn's disease lesions by local injection of mesenchymal stem cells
Protocol code: TJT1707P1MSC
Sponsor: Centre hospitalier universitaire de Liege (Hospital/Clinic/Other health care facility). Phase: Phase I and Phase II (Integrated)- Other. Countries: Belgium (ended).
Therapeutic area(s): Diseases [C] - Digestive System Diseases [C06]
Gender: Female, Male. Age: 18-64 years, 65+ years. Enrolment: 70.
Status: Ended. Start date (EU): 2018-03-01. End date (EU): 2026-04-21. Decision date: 2024-10-09. Results received: No. Last updated: 2025-10-27.

Condition(s): Crohn's Disease
Product: MSC

Primary endpoint: The first co-primary endpoint will be the complete or partial healing of the refractory lesion at 12 weeks., The second co-primary endpoint is safety, assessed by monitoring for adverse and serious adverse events and changes in vital signs at the day of treatment and at all follow-up visits.
Endpoint(s): Complete or partial healing of the refractory lesion at 48 weeks, Evolution of the Patient Reported Outcomes (PRO), between week 0, 12 and 48, including pain, general well-being and number of stools per day, Evolution of Crohn's Disease Activity Index (CDAI) between weeks 0, 12 and 48, Evolution of the Short health scale SHS (quality of life) between week 0, 12 and 48, Evolution of the Lemann Index between week 0, 12 and 48, Evolution of the GETAID obstructive score for Crohn's Disease strictures between weeks 0, 12 and 48, Disappearance or improvement of intestinal or colonic ulcers/stricture at MRI at 12 and 48 weeks, Incidence of specific safety outcomes all over the study period and more specifically at week 0, 4, 12, 24, and 48: (1) the occurrence of an obstruction requiring hospitalisation and fasting for at least 24 hours, (2) the occurrence of an intestinal perforation, (3) the development of an intra-abdominal fistula and/or abscess, (4) perianal abscess, (5) new perianal fistulous track.

Source: https://euclinicaltrials.eu/ctis-public/view/2024-514033-37-00